EU clinical trial 2024-510979-38-00: A Phase 2 Study of Pembrolizumab (MK-3475) every 6 weeks (Q6W) in Participants with Relapsed or Refractory Classical Hodgkin’s Lymphoma (rrcHL) or Relapsed or Refractory Primary Mediastinal Large B-cell Lymphoma (rrPMBCL)
Protocol code: MK-3475-B68
Sponsor: Merck Sharp & Dohme LLC (Pharmaceutical company). Phase: Therapeutic exploratory (Phase II). Countries: Poland (ended), Italy (ended), Czechia (ended).
Therapeutic area(s): Diseases [C] - Neoplasms [C04]
Gender: Female, Male. Age: 18-64 years, 65+ years. Enrolment: 28.
Status: Ended. Start date (EU): 2021-05-27. End date (EU): 2025-10-09. End date: 2025-10-13. Decision date: 2024-07-17. Results received: No. Last updated: 2025-09-30.
Decision dates by country: PL: 2024-07-22, CZ: 2024-07-17, IT: 2024-07-22

Condition(s): Relapsed or refractory Classical Hodgkins Lymphoma and relapsed or refractory Primary Mediastinal Large B-cell Lymphoma
Product: KEYTRUDA 25 mg/mL concentrate for solution for infusion

Primary endpoint: Objective Response Rate (ORR) per Lugano Classification as Assessed by Investigator
Endpoint(s): Objective Response Rate (ORR) per Lugano Classification as Assessed by Blinded Independent Central Review (BICR), Duration of Response (DOR) per Lugano Classification as Assessed by Investigator, Duration of Response (DOR) per Lugano Classification as Assessed by BICR, Area Under the Curve (AUC) of Pembrolizumab, Maximum Serum Concentration (Cmax) of Pembrolizumab, Minimum Serum Concentration (Cmin) of Pembrolizumab, Antidrug Antibody Levels (ADA) for Pembrolizumab, Number of Participants Who Experienced an Adverse Event (AE), Number of Participants Who Discontinued Study Treatment Due to AE

Source: https://euclinicaltrials.eu/ctis-public/view/2024-510979-38-00